EU clinical trial 2025-520755-91-00: Neoadjuvant electrochemotherapy for colorectal cancer - a randomized controlled trial
Sponsor: Region Sjaelland (Hospital/Clinic/Other health care facility). Phase: Therapeutic exploratory (Phase II). Countries: Denmark (temporarily halted).
Therapeutic area(s): Diseases [C] - Neoplasms [C04]
Gender: Female, Male. Age: 18-64 years, 65+ years. Enrolment: 12.
Status: Temporarily halted. Start date (EU): 2025-01-31. Decision date: 2025-01-29. Results received: No. Last updated: 2025-07-08.

Condition(s): Colorectal cancer
Product: Bleomycin ”Baxter”, pulver til injektions- og infusionsvæske, opløsning

Primary endpoint: Evaluation of serious adverse events (from study treatment to surgery), Evaluation of any adverse events reported (within 30 days after study treatment)
Endpoint(s): Changes in the tumor microenvironment, in terms of infiltrating lymphocytes, bulk and spatial gene and protein expression analysis, and spatial distribution and organization of bacteria in situ

Source: https://euclinicaltrials.eu/ctis-public/view/2025-520755-91-00